EU clinical trial 2025-521670-34-00: A randomized, double-blind, placebo-controlled study to evaluate efficacy and safety of early in hospital initiation of inclisiran treatment in patients with acute coronary syndromes: Victorion – RIDES
Protocol code: CKJX839A12309
Sponsor: Novartis Pharma AG (Pharmaceutical company). Phase: Therapeutic confirmatory (Phase III). Countries: Germany (ongoing, recruiting), Hungary (ongoing, recruiting), Poland (ongoing, recruiting), France (ongoing, recruiting), Spain (ongoing, recruiting).
Therapeutic area(s): Diseases [C] - Cardiovascular Diseases [C14]
Gender: Female, Male. Age: 18-64 years, 65+ years. Enrolment: 135.
Status: Ongoing, recruiting. Start date (EU): 2026-03-04. Decision date: 2026-02-16. Results received: No. Last updated: 2026-06-08.
Decision dates by country: HU: 2026-02-20, FR: 2026-02-16, PL: 2026-02-22, ES: 2026-02-18, DE: 2026-02-19

Condition(s): Acute coronary syndrome (ST-elevation myocardial infarction [STEMI] or non-ST-elevation myocardial infarction [NSTEMI]) of recent onset.
Product: ATORVASTATIN, ROSUVASTATIN, ROSUVASTATIN, ROSUVASTATIN, ROSUVASTATIN, Placebo to KJX839 (Inclisiran), ATORVASTATIN, INCLISIRAN, ATORVASTATIN, ATORVASTATIN

Primary endpoint: Percent change in LDL-C from baseline to Day 150
Endpoint(s): • Participants achieving LDL-C <70 mg/dL (yes, no) at Day 150 • Participants achieving LDL-C <55 mg/dL (yes, no) at Day 150 • Participants achieving LDL-C <100 mg/dL (yes, no) (among the subset of participants with LDL-C ≥100 mg/dL at baseline) at Day 150 • Participants achieving ≥50% reduction from baseline in LDL-C (yes, no) at Day 150, • Percent change from baseline to mean LDL-C over the double-blind treatment period (averaged over all post-baseline visits) • Absolute change from baseline to mean LDL-C over the double-blind treatment period (averaged over all post-baseline visits) • Percent change in LDL-C from baseline to Day 30 and Day 90 • Absolute change in LDL-C from baseline to Day 30, Day 90 and Day 150, Percent change and absolute change in PCSK9 from baseline to Day 30, Day 90 and Day 150, Percent change and absolute change from baseline in: apoB, VLDL, non-HDLC, HDL-C, total cholesterol and triglycerides at Day 150, Number and percentage of participants experiencing treatment emergent AEs or SAEs

Source: https://euclinicaltrials.eu/ctis-public/view/2025-521670-34-00